EU clinical trial 2025-523384-37-00: Bioequivalence clinical trial of two formulations of linagliptin
Protocol code: N-LIA-25-297
Sponsor: Laboratorios Normon S.A. (Pharmaceutical company). Phase: Human Pharmacology (Phase I)- Bioequivalence Study. Countries: Spain (ended).
Therapeutic area(s): Not possible to specify
Gender: Female, Male. Age: 18-64 years. Enrolment: 48.
Status: Ended. Start date (EU): 2025-10-10. End date (EU): 2025-12-18. Decision date: 2025-10-08. Results received: No. Last updated: 2025-10-08.

Condition(s): Healthy volunteers

Source: https://euclinicaltrials.eu/ctis-public/view/2025-523384-37-00